EU clinical trial 2024-512501-76-00: ATLAS-PEDS: An open-label, multinational study of fitusiran prophylaxis in pediatric subjects ages 1 to less than 12 years with hemophilia A or B
Protocol code: EFC15467
Sponsor: Genzyme Corp. (Pharmaceutical company). Phase: Phase II and Phase III (Integrated). Countries: Italy (ongoing, recruitment ended), Spain (ongoing, recruitment ended).
Therapeutic area(s): Diseases [C] - Hemic and Lymphatic Diseases [C15]
Gender: Male. Age: 0-17 years. Enrolment: 3.
Status: Ongoing, recruitment ended. Start date (EU): 2020-07-28. Decision date: 2024-06-04. Results received: No. Last updated: 2026-05-22.
Decision dates by country: ES: 2024-06-04, IT: 2024-06-10

Condition(s): Hemophilia
Product: SAR439774

Primary endpoint: Plasma antithrombin (AT) activity levels
Endpoint(s): Number of participants reported with adverse events, Fitusiran plasma concentrations

Source: https://euclinicaltrials.eu/ctis-public/view/2024-512501-76-00